EU clinical trial 2025-520916-32-00: Early administration of ivabradine in hospitalized children for heart failure - Easi-child Pilot study
Protocol code: EASI-Child
Sponsor: Ospedale Pediatrico Bambino Gesu (Hospital/Clinic/Other health care facility). Phase: Therapeutic exploratory (Phase II). Countries: Italy (ongoing, recruiting).
Therapeutic area(s): Diseases [C] - Cardiovascular Diseases [C14]
Gender: Female, Male. Age: 0-17 years. Enrolment: 9.
Status: Ongoing, recruiting. Start date (EU): 2025-03-19. Decision date: 2025-03-18. Results received: No. Last updated: 2026-08-02.

Condition(s): Acute hearth failure in dilated cardiomyopathy
Product: Ivabradine DOC Generici 2,5 mg, filmomhulde tabletten, Ivabradine DOC Generici 5 mg, filmomhulde tabletten

Primary endpoint: Number of patients, both in absolute numbers and as a percentage, showing a clinical response to treatment, defined as the difference (reduction) expressed as a percentage between 20% and 30%, calculated between the baseline (V1) heart rate in bpm and that recorded after 14 days (V3) of stable therapy with ivabradine.
Endpoint(s): Clinical response defined by the difference (reduction) expressed as a percentage, calculated between the heart rate value at baseline (V1) and at the end of the titration protocol (V2), and between the heart rate value recorded at the end of the stable therapy period with ivabradine after 4 months of follow-up (V4), Difference from baseline (V1) in heart rate in bpm at the end of the titration period (V2), after 14 days (V3) of stable therapy with ivabradine. After 4 months of follow-up (V4), Difference from baseline (V1) of serum NT-proBNP in pg/mL (mean (±SD)) at the end of the titration protocol (V2), after 14 days of stable therapy with ivabradine (V3), after 4 months of follow up (V4), Correlation between heart rate and NT-proBNP value (Pearson test), Difference from baseline (V1) in left ventricular function, calculated using 2D echocardiography (calculated left ventricular volumes and ejection fraction - mean (±SD), at the end of the titration protocol (V2), after 14 days of stable ivabradine therapy (V3), after 4 months of follow-up (V4)

Source: https://euclinicaltrials.eu/ctis-public/view/2025-520916-32-00